EU clinical trial 2024-512676-36-00: LCH-IV International Collaborative Treatment Protocol for Children and Adolescents with Langerhans Cell Histiocytosis
Protocol code: 042011
Sponsor: St. Anna Childrens Cancer Research Institute GmbH (Pharmaceutical company). Phase: Phase II and Phase III (Integrated). Countries: Czechia (ongoing, recruitment ended), Netherlands (ongoing, recruitment ended), Italy (ongoing, recruitment ended), Austria (ongoing, recruitment ended), Norway (ongoing, recruitment ended), Spain (ongoing, recruitment ended), Greece (ongoing, recruitment ended), Sweden (ongoing, recruitment ended), Ireland (ongoing, recruitment ended), Poland (ongoing, recruitment ended), Denmark (ongoing, recruitment ended), Belgium (ongoing, recruitment ended).
Therapeutic area(s): Diseases [C] - Neoplasms [C04]
Gender: Female, Male. Age: 0-17 years. Enrolment: 1124.
Status: Ongoing, recruitment ended. Start date (EU): 2024-10-09. Decision date: 2024-10-09. Results received: No. Last updated: 2026-05-22.
Decision dates by country: GR: 2024-10-11, IE: 2024-10-09, IT: 2024-10-14, ES: 2024-10-14, SE: 2024-10-11, NO: 2024-10-09, PL: 2024-10-13, BE: 2024-10-09, CZ: 2024-10-11, AT: 2024-10-14, NL: 2024-10-14, DK: 2024-10-10

Condition(s): Langerhans Cell Histiocytosis
Product: OCTAGAM 10 %, Lösung zur intravenösen Infusion, Cytarabine 20 mg/ml Solution for Injection/Infusion, Fludarabine phosphate 25 mg/ml Concentrate for Solution for Injection or Infusion, Prednisolone 5mg Tablets, Methotrexate 10 mg Tablets, Vinblastine Sulfate 1 mg/ml Solution for Injection or Infusion, Melphalan 50 mg Powder and Solvent for Solution for Injection/Infusion, INDOMETACIN CAPSULES BP 25mg, LEMTRADA 12 mg concentrate for solution for infusion, Mercaptopurine Silver Pharma 50 mg tablets, LITAK 2 mg/ml solution for injection

Primary endpoint: Reactivation-free survival, Overall and disease free survival, To study the course of neurodegenerative CNS-LCH, Response of isolated tumorous CNS lesions to 2-CdA, Rate and spectrum of permanent consequences
Endpoint(s): Incidence of permanent consequences, Toxicity of treatment, Proportion fo patients alive and free of disease without permanent consequences, Cumulative incidence of reactivations in risk organs

Source: https://euclinicaltrials.eu/ctis-public/view/2024-512676-36-00